EU clinical trial 2023-504750-35-01: Randomised, placebo-controlled clinical trial on the efficacy of Roleca® juniper 100 mg for dyspeptic digestive complaints such as cramps in the gastrointestinal tract, flatulence and bloating.
Protocol code: CGB_1109
Sponsor: CGBS GbR (Health care). Phase: Therapeutic use (Phase IV). Countries: Germany (ended).
Therapeutic area(s): Diseases [C] - Digestive System Diseases [C06]
Gender: Female, Male. Age: 18-64 years. Enrolment: 100.
Status: Ended. Start date (EU): 2023-10-24. End date (EU): 2025-02-20. Decision date: 2023-09-26. Results received: Yes. Last updated: 2024-11-05.

Condition(s): Treatment of dyspeptic digestive complaints (cramps in the gastrointestinal tract, flatulence, bloating).
Product: P-Tabletten weiß 7 mm Lichtenstein, Roleca Wacholder 100mg

Primary endpoint: Prospective documentation of the efficacy of Roleca® Juniper 100 mg vs placebo for dyspeptic digestive complaints, based on the improvement in the patients' quality of life, expressed in a change in the score in the Nepean Dyspepsia Index in the patient diary, with particular comparison of the values after the end of treatment (V3) with the values before treatment (V1) (in particular significant improvement in complaints and feeling of pressure in the upper abdomen and feeling of fullness).
Endpoint(s): Prospective documentation of the tolerability, safety and compliance of Roleca® Juniper 100 mg in dyspeptic digestive complaints. Tolerability and safety will be evaluated based on the patient's information in the patient diary regarding tolerability, as well as the number and severity of adverse events reported. Compliance will be analyzed based on documentation of medication taken in the patient diary., Analysis of the intestinal microbiome before and during treatment with Roleca® Wacholder 100 mg for dyspeptic digestive complaints

Source: https://euclinicaltrials.eu/ctis-public/view/2023-504750-35-01